EU clinical trial 2023-510009-16-00: PHASE 1/2, MULTICENTER, DOSE-ESCALATING STUDY TO EVALUATE THE SAFETY, PHARMACOKINETICS, PHARMACODYNAMICS, AND EFFICACY OF QUIZARTINIB ADMINISTERED IN COMBINATION WITH RE-INDUCTION CHEMOTHERAPY, AND AS A SINGLE-AGENT CONTINUATION THERAPY, IN PEDIATRIC RELAPSED/REFRACTORY AML SUBJECTS AGED 1 MONTH TO <18 YEARS (AND YOUNG ADULTS AGED UP TO 21 YEARS) WITH FLT3-ITD MUTATIONS
Protocol code: AC220-A-U202
Sponsor: Daiichi Sankyo Inc. (Pharmaceutical company). Phase: Phase I and Phase II (Integrated)- Other. Countries: Belgium (ended), France (ongoing, recruitment ended), Italy (ongoing, recruitment ended), Sweden (ongoing, recruitment ended), Netherlands (ongoing, recruitment ended), Denmark (ended), Spain (ongoing, recruitment ended).
Therapeutic area(s): Diseases [C] - Hemic and Lymphatic Diseases [C15]
Gender: Female, Male. Age: 0-17 years, 18-64 years. Enrolment: 18.
Start date (EU): 2018-12-04. Decision date: 2024-04-04. Results received: No. Last updated: 2026-05-18.
Decision dates by country: IT: 2024-04-09, SE: 2024-04-05, BE: 2024-04-23, DK: 2024-04-04, FR: 2024-04-23, NL: 2024-04-04, ES: 2024-04-05

Condition(s): Acute Myeloid Leukemia
Product: Quizartinib

Primary endpoint: Efficacy (ie, the primary outcome measure): CRc rate after completion of up to 2 Re-Induction Cycles.(based on investigator’s assessment)., Safety: The safety profile of quizartinib administered in combination with reinduction chemotherapy for up to 2 cycles, with optional consolidation chemotherapy, and as a single-agent continuation therapy over ≤12 cycles. And phase 1 only: Number of DLTs in dose cohorts in Re-Induction Cycle 1, Estimates of AUC, apparent clearance (CL/F), and apparent volume of distribution (Vz/F) for quizartinib and AC886 by the use of PopPK modeling or other applicable methods
Endpoint(s): Efficacy (ie, the secondary outcome measures): CR rate, which is defined as the percent of subjects achieving a CR after completion of up to 2 Re-Induction cycles, CRi rate, which is defined as the percent of subjects achieving CRi after completion of up to 2 Re-Induction Cycles., Duration of CR defined as the time from the first documented CR until documented relapse, Duration of CRi, defined as the time from the first documented CRi until documented relapse, Duration of CRc, defined as the time from the first documented CR or CRi until documented relapse, CR rate after completion of Re-Induction Cycle 1 which is defined as the percent of subjects achieving CR after completion of Re-Induction Cycle 1, CRi rate after completion of Re-Induction Cycle 1, which is defined as the percent of subjects achieving a CRi after completion of Re-Induction Cycle 1, CRc rate after completion of Re-Induction Cycle 1, which is defined as the percent of subjects achieving CR+ CRi after completion of Re- Induction Cycle 1, Time to relapse, defined as the time from the first documented response (CR, CRi) until documented relapse, Rate of relapse after 1, 2 and 3 years, Cumulative incidence of relapse at the end of the study, defined as the percentage of subjects who achieved CRc at the end of Re-Induction and relapse at these defined time points, OS, defined as the time from the start of Re-Induction therapy until death from any cause, EFS defined as the time from the start of Re-Induction therapy until the earliest date of the following: - Refractory disease (or treatmetn failure) at the end of Re-Induction. - Relapse after CR or CRi. - Death from any cause at any time during the study., Pharmacodynamic: Inhibition of FLT3-ITD autophosphorylation activity in an ex-vivo PIA during Re-Induction, Continuation, and at the time of relapse, FLT3-ITD to FLT3-WT allelic ratio at Screening, during Re- Induction, and at the time of relapse, Mutations present in blasts (eg, in the kinase and juxtamembrane domains of FLT3 and other mutations known to be associated with AML) at Screening and at the time of refractory disease or relapse, Biomarker: Rate of CRc (CR, CRi) without MRD using next generation sequencing, Others: Acceptability including palatability of quizartinib formulations

Source: https://euclinicaltrials.eu/ctis-public/view/2023-510009-16-00